EU clinical trial 2024-513649-35-00: SPLEMENGO - Multicenter, randomized, phase III, trial assessing the immunogenicity and safety of three meningococal B vaccine strategies among patients with asplenia
Protocol code: P170938J
Sponsor: Assistance Publique Hopitaux De Paris (Hospital/Clinic/Other health care facility). Phase: Therapeutic confirmatory (Phase III). Countries: France (ongoing, recruitment ended).
Therapeutic area(s): Diseases [C] - Bacterial Infections and Mycoses [C01]
Gender: Female, Male. Age: 18-64 years, 65+ years. Enrolment: 84.
Status: Ongoing, recruitment ended. Start date (EU): 2022-09-15. Decision date: 2024-08-09. Results received: No. Last updated: 2024-08-09.

Condition(s): Asplenia
Product: Bexsero suspension for injection in pre-filled syringe Meningococcal group B Vaccine (rDNA, component, adsorbed), Trumenba suspension for injection in pre-filled syringe Meningococcal group B vaccine (recombinant, adsorbed)

Primary endpoint: Proportion of responders defined as participants with seroconversion (i.e. hSBA titer increases from <4 before vaccination to at least 4) or with hSBA titer showing a 4-fold increase (if hSBA titer was at least 4 before vaccination) one month after the completeness of three anti-meningococci B vaccine strategies (at M7 for all arms) in asplenic adults.

Source: https://euclinicaltrials.eu/ctis-public/view/2024-513649-35-00